EU clinical trial 2024-513883-24-00: A national randomized placebo-controlled double-blind multicenter trial of LT4/LT3 combination therapy in patients with autoimmune hypothyroidism: the T3-4-Hypo trial
Sponsor: Erasmus Universitair Medisch Centrum Rotterdam (Erasmus MC), ZonMW (Hospital/Clinic/Other health care facility, Laboratory/Research/Testing facility). Phase: Therapeutic confirmatory (Phase III). Countries: Netherlands (authorised, recruiting).
Therapeutic area(s): Diseases [C] - Hormonal diseases [C19]
Gender: Female, Male. Age: 18-64 years, 65+ years. Enrolment: 600.
Status: Authorised, recruiting. Start date (EU): 2025-11-02. Decision date: 2024-11-27. Results received: No. Last updated: 2025-07-11.

Condition(s): Hypothyroidism; Triiodothyronine; Quality of Life; Persistant complaints
Product: LIOTHYRONINE SODIUM, LEVOTHYROXINE SODIUM, Placebo tablets are white, round, biconvex tablets. The tablets contain no active pharmaceutical ingredient (API), but are manufactured following the manufacturing process of the liothyronine tablets presented in the IMPD for liotyronine 2, 2.5, 3.75, and 5 µg

Primary endpoint: Mean change from baseline to 52 weeks in the ThyPRO tiredness subscale scores.
Endpoint(s): 1. Mean change from baseline to 52 weeks in the ThyPRO-39 composite scale* scores. 2. Improvement from baseline to 52 weeks in the ThyPRO tiredness subscale scores ≥ minimal important difference (=14.3). 3. Mean change from baseline to 52 weeks in the ThyPRO tiredness subscale scores in participants with a baseline score > 57 (= population mean, unpublished results; personal communication with Dr T Watt, developer of the ThyPRO questionnaire)., 4. Mean change from baseline to 52 weeks in the ThyPRO tiredness subscale scores in participants with a normal-range TSH level at 52 weeks. 5. Determinants of the effects of LT4/LT3 combination therapy on tiredness. 6. The (determinants of the) effects of LT4/LT3 combination therapy compared to LT4 therapy alone on other thyroid related complaints and quality of life., 7. The (determinants of the) effects of LT4/LT3 combination therapy compared to LT4 therapy alone on cardiovascular, metabolic, and bone outcomes. 8. The (determinants of the) effects of LT4/LT3 combination therapy compared to LT4 therapy alone on neurocognitive function. 9. Economic evaluation including cost-effectiveness analysis comparing LT4/LT3 combination therapy and LT4 monotherapy., 10. Number of adverse events in the LT4/LT3 combination therapy compared to the LT4 monotherapy groups

Source: https://euclinicaltrials.eu/ctis-public/view/2024-513883-24-00